EU clinical trial 2023-508825-29-00: A Randomized, Parallel, Open-Label, Phase 1/2a Study to Assess the Safety and Tolerability of Multiple Doses of the Bacteriophage Cocktail TP-122 (Component TP-122A), for the Treatment of Ventilator-Associated Pneumonia
Sponsor: Technophage Investigacao E Desenvolvimento Em Biotecnologia S.A. (Pharmaceutical company). Phase: Phase I and Phase II (Integrated)- First administration to humans. Countries: France (not authorised).
Therapeutic area(s): Diseases [C] - Respiratory Tract Diseases [C08]
Gender: Female, Male. Age: 18-64 years, 65+ years. Enrolment: 15.
Status: Not authorised. Decision date: 2024-02-26. Results received: No. Last updated: 2024-02-26.

Condition(s): Ventilator-Associated Pneumonia
Product: TP-122

Primary endpoint: Analysis of TP-122A arm with SoC versus SoC alone, and individual analysis per treatment arm of the following assessments:, 1.a. Adverse Events (AEs): a. Incidence of treatment-emergent adverse events (AE). b. Incidence of treatment-emergent serious adverse events (SAEs). Note: including analysis of seriousness, severity, causality,, 1.b. Clinical laboratory parameters c. Changes from baseline in clinical laboratory parameters. d. Clinical laboratory parameters abnormalities shift tables. Note: Time frames: dosing days 3, End Of Treatment (EOT)/Early Discontinuation (ED) and followup period (FUp1 and Fup2), 1.c. Vital signs e. Changes from baseline in vital signs. f. Vital signs abnormalities shift tables. Note: Time frames: dosing days (3 and 7/EOT), and follow-up period (FUp1 and FUp2)., 1.d. Electrocardiogram (ECG) g. Changes from baseline in ECG. h. ECG abnormalities shift tables. Note: Time frames: baseline, dosing day 3, EOT/ED, and FUp (FUp1 and FUp2).
Endpoint(s): Proportion of subjects achieving “Clinical Cure” clinical response (CR) (time frames: dosing days (1 to 7) and FUp1, Time to achieve “Clinical Cure” CR, Proportion of subjects achieving “Eradication” or “Presumed Eradication” microbiological response (MR) of TP-122A target bacteria (time frames: dosing days (1 to 7), FUp1 and FUp2, Time to achieve “Eradication” or “Presumed Eradication” MR, Number of days with mechanical ventilator (MV), from first dose of investigational product (IP) to FUp1., Number of days in ICU from first dose of IP to FUp2, Survival: all-cause mortality, at FUp2.

Source: https://euclinicaltrials.eu/ctis-public/view/2023-508825-29-00